EU clinical trial 2025-521199-80-00: Study PACIFIC: Fixed duration treatment with combined pirtobrutinib and short course immuno-chemotherapy in fit patients with previously untreated symptomatic chronic lymphocytic leukemia (CLL). A phase II FILO trial
Protocol code: FILOCLL016-PACIFIC
Sponsor: French Innovative Leukemia Organization (Laboratory/Research/Testing facility). Phase: Therapeutic exploratory (Phase II). Countries: France (authorised, recruitment pending).
Therapeutic area(s): Diseases [C] - Hemic and Lymphatic Diseases [C15]
Gender: Female, Male. Age: 18-64 years, 65+ years. Enrolment: 82.
Status: Authorised, recruitment pending. Decision date: 2025-11-05. Results received: No. Last updated: 2025-11-05.

Condition(s): Patients with previously untreated symptomatic chronic lymphocytic leukemia.
Product: PIRTOBRUTINIB

Primary endpoint: Peripheral blood with undetectable (<10-4) minimal residual disease at month 24.
Endpoint(s): PB MRD at month 9 and 18 and BM MRD at month 24, Progression free survival (PFS), disease-free survival (DFS), event-free survival (EFS), overall survival (OS) and time to next treatment (TTNT)

Source: https://euclinicaltrials.eu/ctis-public/view/2025-521199-80-00